EU clinical trial 2024-519158-34-00: MESOTHERAPY IN LATERAL EPICONDYLITIS, A RANDOMIZED, DOUBLE- BLIND STUDY TO COMPARE THE EFFICACY OF MESOTHERAPY WITH PIROXICAM AND LIDOCAINE VERSUS INTRADERMAL DRY NEEDLING, IN THE TREATMENT OF LATERAL EPICONDYLITIS
Protocol code: CIC-10
Sponsor: Unidade Local De Saude De Santa Maria E.P.E., Instituto De Medicina Molecular Joao Lobo Antunes (Hospital/Clinic/Other health care facility, Laboratory/Research/Testing facility). Phase: Therapeutic exploratory (Phase II). Countries: Portugal (ongoing, recruiting).
Therapeutic area(s): Diseases [C] - Musculoskeletal Diseases [C05]
Gender: Female, Male. Age: 18-64 years, 65+ years. Enrolment: 85.
Status: Ongoing, recruiting. Start date (EU): 2025-01-10. Decision date: 2025-01-09. Results received: No. Last updated: 2025-01-09.

Condition(s): lateral epicondylitis
Product: PIROXICAM, LIDOCAINE HYDROCHLORIDE

Primary endpoint: Changes from baseline in pain intensity quantified by using a 0-100 VAS score. We will consider the treatment effective if a reduction of 20/100 in the VAS score is achieved.
Endpoint(s): - Changes from baseline in a three-point scale that measures pain on resisted dorsiflexion of the wrist and third finger, registered as none, some or definite, at 1 week, 2 weeks, 3 weeks, 1 month and 3 months. - Changes from baseline in general health evaluation with the short form-36 mental health (SF- 36 MH), at 1 week, 2 weeks, 3 weeks, 1 month, 3 months and 6 months

Source: https://euclinicaltrials.eu/ctis-public/view/2024-519158-34-00